EU clinical trial 2023-508424-34-00: A Phase 3b, Randomized, Double-blind, Parallel Group, Multicenter Study to Evaluate Further Therapeutic Strategies with Guselkumab in Patients with Moderate-to-Severe Plaque-Type Psoriasis
Protocol code: CNTO1959PSO3012
Sponsor: Janssen Cilag International (Pharmaceutical company). Phase: Therapeutic confirmatory (Phase III). Countries: Germany (ended).
Therapeutic area(s): Diseases [C] - Immune System Diseases [C20]
Gender: Female, Male. Age: 18-64 years, 65+ years. Enrolment: 828.
Status: Ended. Start date (EU): 2019-02-11. End date (EU): 2025-01-07. Decision date: 2024-06-05. Results received: Yes. Last updated: 2024-12-04.

Condition(s): Moderate to Severe Plaque Type Psoriasis
Product: Guselkumab 1 mL PFS Placebo, Guselkumab - solution for injection in pre-filled syringe - 100 mg/mL

Primary endpoint: The primary endpoint of the main study is the proportion of subjects in study groups 2a and 2b who achieve an absolute PASI score <3 at week 68.

Source: https://euclinicaltrials.eu/ctis-public/view/2023-508424-34-00